EU clinical trial 2024-513206-65-00: A phase III randomized trial of post-operative adjuvant nivolumab and concomitant chemo-radiotherapy in high-risk patients with resected squamous cell carcinoma of head and neck (SCCHN)
Protocol code: GORTEC 2018-01
Sponsor: Groupe Oncologie Radiotherapie Tete Cou (Patient organisation/association). Phase: Therapeutic confirmatory (Phase III). Countries: Belgium (ongoing, recruitment ended), Poland (ongoing, recruitment ended), France (ongoing, recruitment ended), Greece (ongoing, recruitment ended), Spain (ongoing, recruitment ended).
Therapeutic area(s): Diseases [C] - Neoplasms [C04]
Gender: Female, Male. Age: 18-64 years, 65+ years. Enrolment: 675.
Status: Ongoing, recruitment ended. Start date (EU): 2018-08-10. Decision date: 2024-07-24. Results received: No. Last updated: 2025-03-31.
Decision dates by country: BE: 2024-07-24, GR: 2024-09-12, PL: 2024-07-25, ES: 2024-07-26, FR: 2024-07-24

Condition(s): resected squamous cell carcinoma of head and neck
Product: CISPLATINE ACCORD 1 mg/ml, solution à diluer pour perfusion, OPDIVO 10 mg/mL concentrate for solution for infusion.

Primary endpoint: Disease free survival (DFS by investigator imaging assessments) defined as the time between the date of randomization and the date of first loco-regional or distant recurrence or death (of any cause) whichever occurs first,..
Endpoint(s): Overall survival, DFS by blinded independent central imaging review, DFS and OS by PDL-1 status, Cumulative incidence of locoregional failure, cumulative incidence of distant metastatic failure and cumulative incidence of death without previous progression, Incidence of second primary malignancy (SCC to a distance >= 3 cm from the tumor bed and that will clearly not be attributable to a relapse or a second cancer arising outside the upper aero digestive track)., Safety: Adverse events and laboratory abnormalities as graded by National Cancer Institute Common Terminology Criteria for Adverse Events (NCI-CTCAE v5.0). Incidence of delayed toxicity of radiotherapy (e.g. dysphagia, chronic swallowing dysfunctions, speech problems, cervical fibrosis, rate and duration of the use of feeding tubes)., Correlation between the immune landscape and patients’ outcome

Source: https://euclinicaltrials.eu/ctis-public/view/2024-513206-65-00